EU clinical trial 2023-504831-42-00: IRIMAD Interest of postoperative reintroduction of chemotherapy in patients with colorectal liver metastases who responded well to preoperative chemotherapy with FOLFIRI with or without targeted therapy
Protocol code: APHP220917
Sponsor: Assistance Publique Hopitaux De Paris (Hospital/Clinic/Other health care facility). Phase: Therapeutic confirmatory (Phase III). Countries: France (ongoing, recruiting).
Therapeutic area(s): Diseases [C] - Digestive System Diseases [C06]
Gender: Female, Male. Age: 18-64 years, 65+ years. Enrolment: 254.
Status: Ongoing, recruiting. Start date (EU): 2025-06-27. Decision date: 2024-05-23. Results received: No. Last updated: 2026-07-23.

Condition(s): patient with colorectal cancer with hepatic metastasis
Product: FLUOROURACIL, CALCIUM FOLINATE, METHYLPREDNISOLONE, ONDANSETRON, CALCIUM LEVOFOLINATE, IRINOTECAN

Primary endpoint: Disease-free survival rate at 3 years
Endpoint(s): Overall survival at 3 years, Liver-free survival at 3 years, Extra -hepatic recurrence rate, Safety including chemotherapy associated toxicity assessed by International Common Terminology Criteria for Adverse Events (CTCAE) grading system, Compliance defined as the ability to administrate a total of 12 cycles of FOLFIRI-based chemotherapy including preoperative treatment, Rate of treatment of recurrence with curative intent

Source: https://euclinicaltrials.eu/ctis-public/view/2023-504831-42-00